EU clinical trial 2024-519168-42-00: Phase I study of anti-GD2 Chimeric Antigen Receptor-Expressing T cells in pediatric and young adult patients affected by relapsed/refractory central nervous system tumors
Protocol code: GD2CAR02
Sponsor: Ospedale Pediatrico Bambino Gesu (Hospital/Clinic/Other health care facility). Phase: Human Pharmacology (Phase I)- Other. Countries: Italy (ongoing, recruiting).
Therapeutic area(s): Diseases [C] - Neoplasms [C04]
Gender: Female, Male. Age: 0-17 years, 18-64 years. Enrolment: 27.
Status: Ongoing, recruiting. Start date (EU): 2025-02-05. Decision date: 2025-02-04. Results received: No. Last updated: 2025-10-03.

Condition(s): Relapsed/refractory malignant central nervous system tumors
Product: CYCLOPHOSPHAMIDE, FLUDARABINE

Primary endpoint: 1.To evaluate the safety of the infusion of iC9-GD2-CAR-T cells at different escalating/de-escalating doses and establish the dose limiting toxicity (DLT) of the cellular product. Toxicity, both systemic and neurological, will be evaluated according to the Common Terminology Criteria for Adverse Event scale, version 5.0, and to specific grading scales. DLT will be defined as any of the following that is not pre-existing, due to infection or to underlying malignancy and that may be considered pos
Endpoint(s): 1. To assess the in vivo persistence and expansion of the infused CAR T-cells in the peripheral blood (PB) and CSF using immunoassays and transgene detection (Real Time q Polymerase Chain Reaction (PCR)) both for the whole population and the specific T cells subsets 2. To evaluate the tumor infiltration of the infused T cells by immunohistochemistry (IHC), flow cytometry and/or transgene detection (Real Time qPCR), whenever the tumor sample is available after the treatment 3. To assess the kinet

Source: https://euclinicaltrials.eu/ctis-public/view/2024-519168-42-00